EU clinical trial 2023-508976-12-00: Rapid pain control in Ixekizumab targeted axial spondyloarthritis
Protocol code: RAPIDA
Sponsor: Universitaetsklinikum Erlangen AöR (Hospital/Clinic/Other health care facility). Phase: Therapeutic use (Phase IV). Countries: Germany (ended).
Therapeutic area(s): Diseases [C] - Immune System Diseases [C20]
Gender: Female, Male. Age: 18-64 years, 65+ years. Enrolment: 10.
Status: Ended. Start date (EU): 2024-04-29. End date (EU): 2025-12-22. Decision date: 2024-01-29. Results received: No. Last updated: 2024-01-29.

Condition(s): axial spondyloarthritis
Product: Taltz 80 mg solution for injection in pre-filled pen

Primary endpoint: Change in fMRI BOLD signal voxel count during initial treatment with Ixekizumab (day 17 vs. day 14) as compared to change in fMRI BOLD signal voxel count during pre-treatment (day 3 vs. day 0)

Source: https://euclinicaltrials.eu/ctis-public/view/2023-508976-12-00